EU clinical trial 2023-510145-25-00: A Phase IIIb, Open-label, Multi-center Study to Evaluate the Immunogenicity and Safety of a Booster Dose and Describe the Immune Persistence of MenACYW Conjugate Vaccine with 5- and/or 10-year Booster Doses in Children and Adolescents who had been Primed with MenACYW Conjugate Vaccine as Toddlers
Protocol code: MEQ00073
Sponsor: Sanofi Pasteur (Pharmaceutical company). Phase: Therapeutic confirmatory (Phase III). Countries: Germany (ongoing, recruitment ended), Finland (ongoing, recruitment ended), Hungary (ongoing, recruitment ended), Spain (ongoing, recruitment ended).
Therapeutic area(s): Diseases [C] - Bacterial Infections and Mycoses [C01]
Gender: Female, Male. Age: 0-17 years. Enrolment: 209.
Status: Ongoing, recruitment ended. Start date (EU): 2022-08-23. Decision date: 2024-05-01. Results received: No. Last updated: 2026-07-23.
Decision dates by country: ES: 2024-05-07, HU: 2024-05-03, DE: 2024-05-01, FI: 2024-05-03

Condition(s): Meningococcal infection
Product: MenQuadfi solution for injection Meningococcal Group A, C, W and Y conjugate vaccine

Primary endpoint: Vaccine seroresponse against meningococcal serogroups A, C, W, and Y
Endpoint(s): Antibody titers against meningococcal serogroups A, C, W, and Y before the administration of a booster dose of MenACYW conjugate vaccine (Group 1 and 2), Antibody titers against meningococcal serogroups A, C, W, and Y at Visit 2 (Group 2), Antibody titers against meningococcal serogroups A, C, W, and Y at Visit 3 (Group 1), Antibody titers against meningococcal serogroups A, C, W, and Y at Visit 1 and Visit 2 (Group 1), Antibody titers against meningococcal serogroups A, C, W, and Y at Visit 2 and Visit 3 (Group 2), Antibody titers against meningococcal serogroups A, C, W, and Y at Visit 3 and Visit 4 (Group 1), Antibody concentrations against tetanus toxoid at Visit 1 and Visit 2 (Group 1), Antibody concentrations against tetanus toxoid at Visit 3 and Visit 4 (Group 1), Antibody concentrations against tetanus toxoid at Visit 2 and Visit 3 (Group 2), Antibody titers against meningococcal serogroup C Visit 3 and Visit 4 (Group 1), Antibody titers against meningococcal serogroup C Visit 2 and Visit 3 (Group 2), Number of participants with immediate unsolicited systemic adverse events (AEs), Number of participants with solicited injection site reactions and systemic reactions, Number of participants with unsolicited AEs, Number of participants with serious adverse events (SAEs) and Adverse Event of Special Interest (AESI)

Source: https://euclinicaltrials.eu/ctis-public/view/2023-510145-25-00